EU clinical trial 2024-518359-47-00: A Pivotal Phase 2/3, Multi-Center, Randomized, Double-Blind, Placebo-Controlled, Adaptive Design Study of L Annamycin for Injection in Combination with Cytarabine Injection Versus Placebo in Combination with Cytarabine Injection as Second Line Therapy for Remission Induction in Adult Subjects with Refractory/Relapsed Acute Myeloid Leukemia
Protocol code: MB-108
Sponsor: Moleculin Biotech Inc. (Pharmaceutical company). Phase: Phase II and Phase III (Integrated). Countries: Belgium (authorised, recruitment pending), Italy (ongoing, recruiting), Germany (authorised, recruitment pending), Czechia (authorised, recruitment pending), Spain (ongoing, recruiting), Poland (authorised, recruiting), Lithuania (authorised, recruiting), Romania (ongoing, recruiting), France (authorised, recruitment pending).
Therapeutic area(s): Diseases [C] - Neoplasms [C04]
Gender: Female, Male. Age: 18-64 years, 65+ years. Enrolment: 177.
Start date (EU): 2025-06-17. Decision date: 2025-04-30. Results received: No. Last updated: 2026-04-27.
Decision dates by country: BE: 2025-04-30, CZ: 2025-05-02, FR: 2025-05-06, DE: 2025-04-30, IT: 2025-04-30, LT: 2025-05-05, RO: 2025-07-22, ES: 2025-05-05, PL: 2025-05-05

Condition(s): Acute Myeloid Leukemia
Product: CYTARABINE, CYTARABINE, Liposomal Annamycin, 0.9% Sodium Chloride Injection, USP/Ph. Eur./BP/JP

Primary endpoint: Rate of CR after one treatment cycle (35 days ± 14 days after initiation of randomized treatment)
Endpoint(s): DoR, OS, Rate of subsequent transplantation (i.e., alloHSCT/autoHSCT) for subjects who achieve CR or CRh at 35 days ± 14 days after initiation of randomized treatment (CR + CRh), Pharmacokinetics of annamycin (Part A and Part B), annamycinol (Part A and Part B), and cytarabine (Part A)., Safety, Tolerability

Source: https://euclinicaltrials.eu/ctis-public/view/2024-518359-47-00